EU clinical trial 2024-517432-21-00: An Open-label, Global, Multi-Arm Study to Evaluate the Efficacy and Safety of Relacorilant in Combination with Different Treatment Regimens in Patients with Gynecological Cancers (BELLA)
Protocol code: CORT125134-557
Sponsor: Corcept Therapeutics Inc. (Pharmaceutical company). Phase: Therapeutic exploratory (Phase II). Countries: Italy (ongoing, recruiting), Germany (ongoing, recruiting), France (ongoing, recruiting), Poland (ongoing, recruiting), Belgium (ongoing, recruiting), Spain (ongoing, recruiting).
Therapeutic area(s): Diseases [C] - Neoplasms [C04]
Gender: Female. Age: 18-64 years, 65+ years. Enrolment: 177.
Status: Ongoing, recruiting. Start date (EU): 2025-05-30. Decision date: 2025-05-12. Results received: No. Last updated: 2026-05-26.
Decision dates by country: BE: 2025-05-28, ES: 2025-06-26, IT: 2025-05-14, DE: 2025-05-14, PL: 2025-05-19, FR: 2026-04-14

Condition(s): Gynecological Cancers
Product: BEVACIZUMAB, PACLITAXEL ALBUMIN-BOUND, CORT125134, relacorilant

Primary endpoint: To evaluate PFS as the time from enrollment until first documented progressive disease (PD) by Response Evaluation Criteria in Solid Tumors (RECIST) version 1.1 as determined by the Investigator, or death due to any cause, whichever occurs first.
Endpoint(s): ORR: To evaluate the proportion of patients with measurable disease at Baseline who attain complete response (CR) or partial response (PR) by RECIST version 1.1 • [Time Frame: Date of first dose until PD or death, up to 18 months], BOR: To evaluate the BOR by RECIST version 1.1 recorded from the date of enrollment until PD or death • [Time Frame: Date of first dose until PD or death, up to 18 months], DOR: To evaluate DOR as the time from the first CR or PR to first objectively documented PD or death, whichever comes first. • [Time Frame: Time of first objective response until PD or death, up to 18 months], CBR: To evaluate CBR as the proportion of patients who attain CR, PR, or stable disease (SD) at Week 24 as per RECIST version 1.1. • [Time Frame: Week 24], OS: To evaluate the probability of OS survival at 6, 12, and 18 months. • [Time Frame: Date of first dose up to 6, 12, and 18 months], Number of patients with one or more adverse events • [Time Frame: Date of first dose up to 30 days after last dose]

Source: https://euclinicaltrials.eu/ctis-public/view/2024-517432-21-00